EU clinical trial 2022-502514-86-00: A study to evaluate the effects and safety of INCA033989 in participants with myelofibrosis or essential thrombocythemia
Protocol code: INCA 33989-101
Sponsor: Incyte Corp. (Pharmaceutical company). Phase: Human Pharmacology (Phase I)- First administration to humans. Countries: Spain (ongoing, recruiting), Germany (ongoing, recruiting), Italy (ongoing, recruiting), France (ongoing, recruiting), Denmark (ongoing, recruiting).
Therapeutic area(s): Diseases [C] - Neoplasms [C04]
Gender: Female, Male. Age: 18-64 years, 65+ years. Enrolment: 130.
Status: Ongoing, recruiting. Start date (EU): 2024-02-07. Decision date: 2024-01-19. Results received: No. Last updated: 2026-03-20.
Decision dates by country: ES: 2024-01-19, DK: 2024-05-08, DE: 2024-01-23, FR: 2024-01-29, IT: 2024-01-23

Condition(s): Myeloproliferative Neoplasms

Source: https://euclinicaltrials.eu/ctis-public/view/2022-502514-86-00